EU clinical trial 2023-507494-18-00: Randomized, Open Label, Multicenter, Phase III Study of Entrectinib Versus Crizotinib in Patients with Locally Advanced or Metastatic Non-Small Cell Lung Cancer Harboring ROS1 Gene Rearrangements with and Without Central Nervous System Metastases
Protocol code: MO41552
Sponsor: F. Hoffmann-La Roche AG (Pharmaceutical company). Phase: Therapeutic confirmatory (Phase III). Countries: Slovakia (ongoing, recruitment ended), Croatia (ongoing, recruitment ended), Sweden (ongoing, recruitment ended), Netherlands (ongoing, recruitment ended), Italy (ongoing, recruitment ended), France (ongoing, recruitment ended), Greece (ongoing, recruitment ended), Romania (ongoing, recruitment ended), Spain (ongoing, recruitment ended), Germany (ongoing, recruitment ended).
Therapeutic area(s): Diseases [C] - Neoplasms [C04]
Gender: Female, Male. Age: 18-64 years, 65+ years. Enrolment: 91.
Status: Ongoing, recruitment ended. Start date (EU): 2021-09-24. Decision date: 2024-02-16. Results received: No. Last updated: 2026-07-29.
Decision dates by country: HR: 2024-02-20, GR: 2024-03-29, IT: 2024-03-27, RO: 2024-02-21, ES: 2024-02-16, SK: 2024-02-16, DE: 2024-02-27, NL: 2024-02-16, FR: 2024-02-21, SE: 2024-02-16

Condition(s): Non-small cell lung cancer with ROS proto-oncogene 1, receptor tyrosine kinase (ROS1) gene rearrangements
Product: Rozlytrek, Rozlytrek, Rozlytrek, Rozlytrek, XALKORI 250 mg hard capsules, Rozlytrek, Rozlytrek 200 mg hard capsules, Rozlytrek, XALKORI 200 mg hard capsules, Rozlytrek 100 mg hard capsules, XALKORI 200 mg hard capsules, Rozlytrek, Rozlytrek, XALKORI 250 mg hard capsules, Rozlytrek, Rozlytrek

Primary endpoint: 1. Progression-free survival (PFS) in patients with CNS metastases at baseline, defined as the time from randomization to the first documented disease progression (extracranial or intracranial) or death from any cause, whichever occurs first, as determined by a blinded independent review committee (BIRC) using RECIST v1.1
Endpoint(s): 1. Progression-free survival in the CNS (CNS-PFS), defined as the time from randomization to the first documented disease progression in the CNS or death from any cause, whichever occurs first, as determined by the BIRC using RECIST v1.1, 2. Overall response rate (ORR), defined as the percentage of patients who attain CR or PR, as assessed by the BIRC and the investigator per RECIST v1.1, 3. Duration of response (DOR), defined as the time from when response (CR or PR) is first documented to disease progression or death, whichever occurs first, as assessed by the BIRC and the investigator per RECIST v1.1, 4. Progression-free survival (PFS), defined as the time from randomization to the first documented disease progression (extracranial or intracranial) or death from any cause, whichever occurs first, as determined by the BICR and investigator using RECIST v1.1, 5. Overall survival (OS), defined as the time from randomization to death from any cause, 6. Impact on functioning, including health-related quality of life, using the Global Health Status/Quality of Life (GHS/QoL), the Physical Functioning (PF) and Role Function (RF) scores, as assessed by the EORTC QLQ-C30 and analyzed as a time to first and confirmed clinically meaningful deterioration, 7. Impact on lung cancer-specific symptoms, as assessed by the EORTC QLQ-LC13, 8. Objective response rate in the CNS (CNS-ORR), defined as the percentage of patients who attain CR or PR for lesions in the CNS, as determined by the BICR per RECIST v1.1, 9. Duration of response in the CNS (CNS-DOR), defined as the time from when a CNS response (CR or PR) is first documented to disease progression in the CNS, as determined by the BICR per RECIST v1.1, 10. Incidence, type, timing, relatedness and severity of adverse events , including serious adverse events and adverse events leading to dose modifications/interruptions, study drug withdrawal or death, as assessed by the investigator according to the National Cancer Institute Common Terminology Criteria for Adverse Events, Version 5.0, 11. Health utility from the EQ-5D-5L and pharmacoeconomic model

Source: https://euclinicaltrials.eu/ctis-public/view/2023-507494-18-00